EU clinical trial 2023-506771-10-00: I3Y-MC-JPEF: postMONARCH: A Randomized, Double Blind, Placebo-Controlled, Phase 3 Study to Compare the Efficacy of Abemaciclib Plus Fulvestrant to Placebo Plus Fulvestrant in Participants With HR+, HER2-, Advanced or Metastatic Breast Cancer Following Progression on a CDK4 & 6 Inhibitor and Endocrine Therapy
Protocol code: I3Y-MC-JPEF
Sponsor: Eli Lilly & Co. (Pharmaceutical company). Phase: Therapeutic confirmatory (Phase III). Countries: Italy (ongoing, recruitment ended), Czechia (ended), Greece (ended), Hungary (ended), Belgium (ended), Denmark (ended), Poland (ended), Spain (ongoing, recruitment ended), France (ended).
Therapeutic area(s): Diseases [C] - Neoplasms [C04]
Gender: Female, Male. Age: 18-64 years, 65+ years. Enrolment: 154.
Start date (EU): 2022-03-11. Decision date: 2024-02-26. Results received: No. Last updated: 2026-03-05.
Decision dates by country: PL: 2024-03-15, DK: 2024-02-26, FR: 2024-03-01, HU: 2024-02-29, IT: 2024-02-28, CZ: 2024-02-27, GR: 2024-04-01, BE: 2024-02-26, ES: 2024-03-01

Condition(s): Breast Neoplasm, Neoplasm Metastasis
Product: Placebo to match abemaciclib, Verzenios 50 mg film-coated tablets, FULVESTRANT

Primary endpoint: Progression-Free Survival (PFS)

Source: https://euclinicaltrials.eu/ctis-public/view/2023-506771-10-00